EU clinical trial 2023-503439-16-00: A Phase 1b/2 Dose Escalation and Expansion Study of the Combination of the Bispecific T Cell Redirection Antibodies Talquetamab and Teclistamab in Participants with Relapsed or Refractory Multiple Myeloma
Protocol code: 64007957MMY1003
Sponsor: Janssen - Cilag International (Pharmaceutical company). Phase: Phase I and Phase II (Integrated)- Other. Countries: Spain (ongoing, recruitment ended).
Therapeutic area(s): Diseases [C] - Hemic and Lymphatic Diseases [C15]
Gender: Female, Male. Age: 18-64 years, 65+ years. Enrolment: 51.
Status: Ongoing, recruitment ended. Start date (EU): 2020-12-29. Decision date: 2024-08-14. Results received: No. Last updated: 2026-04-20.

Condition(s): Multiple Myeloma
Product: teclistamab, JNJ-64407564, JNJ-64407564, teclistamab, DARZALEX 1800 mg solution for injection

Primary endpoint: Part 1 and Part 2 •Incidence and severity of DLTs •Incidence and severity of AEs and SAEs, Part 3 •ORR as evaluated by IRC

Source: https://euclinicaltrials.eu/ctis-public/view/2023-503439-16-00